EU clinical trial 2023-507993-42-00: A Phase 1b/2, Open-Label, Multicenter Study to Evaluate the Safety and Pharmacokinetics of a Modified Tafasitamab IV Dosing Regimen Combined with Lenalidomide (LEN) in Patients with Relapsed or Refractory Diffuse Large B-Cell Lymphoma (R/R DLBCL) (MINDway)
Protocol code: MOR208C115
Sponsor: Incyte Corp. (Pharmaceutical company). Phase: Phase I and Phase II (Integrated)- Other. Countries: Austria (ended), Poland (ongoing, recruitment ended), Italy (ended), Czechia (ongoing, recruitment ended), Spain (ended).
Therapeutic area(s): Diseases [C] - Hemic and Lymphatic Diseases [C15]; Diseases [C] - Neoplasms [C04]
Gender: Female, Male. Age: 18-64 years, 65+ years. Enrolment: 38.
Start date (EU): 2022-03-17. Decision date: 2024-03-12. Results received: No. Last updated: 2026-03-07.
Decision dates by country: AT: 2024-03-18, IT: 2024-03-13, ES: 2024-03-12, PL: 2024-03-20, CZ: 2024-03-13

Condition(s): Relapsed or Refractory Diffuse Large B-Cell Lymphoma (DLBCL)
Product: Zelvina 10 mg hard capsules, Zelvina 25 mg hard capsules, MINJUVI 200 mg powder for concentrate for solution for infusion, Zelvina 5 mg hard capsules

Primary endpoint: Incidence and severity of TEAEs (TEAE, treatment-emergent adverse event)
Endpoint(s): • Tafasitamab serum concentrations after 3 (Ctrough and Cmax) and 12 (Ctrough) treatment cycles, • Best Objective Response Rate (ORR) by Investigator assessment up to treatment Cycle 12 based on Cheson et al. (2007), • Duration of Response (DoR) by Investigator assessment based on Cheson et al. (2007), • Progression-Free Survival (PFS) by Investigator assessment based on Cheson et al. (2007), • Number and percentage of patients developing anti- tafasitamab antibodies up to treatment Cycle 12

Source: https://euclinicaltrials.eu/ctis-public/view/2023-507993-42-00